EU clinical trial 2023-509397-39-00: An Adaptive, Open-Label, Dose-Finding, Phase 1/2 Study Investigating the Safety, Pharmacokinetics, and Clinical Activity of Rilzabrutinib (PRN1008), an Oral BTK Inhibitor, in Patients with Relapsed Immune Thrombocytopenia
Protocol code: DFI17124
Sponsor: Principia Biopharma Inc. (Pharmaceutical company). Phase: Phase I and Phase II (Integrated)- Other. Countries: Czechia (ended), Netherlands (ended), Bulgaria (ended).
Therapeutic area(s): Diseases [C] - Hemic and Lymphatic Diseases [C15]
Gender: Female, Male. Age: 18-64 years, 65+ years. Enrolment: 12.
Status: Ended. Start date (EU): 2018-03-20. End date (EU): 2025-12-11. End date: 2025-12-12. Decision date: 2024-02-15. Results received: No. Last updated: 2025-11-25.
Decision dates by country: NL: 2024-02-15, BG: 2024-03-22, CZ: 2024-02-20

Condition(s): Immune Thrombocytopenia
Product: Rilzabrutinib

Primary endpoint: Part A and B: Incidence of treatment-emergent adverse events (TEAEs), Part A: Consecutive Increased Platelet Counts, Part B: Sustained Increase in Platelet Counts
Endpoint(s): Part A: Percent of weeks with platelet counts ≥ 50,000/μL by dose level and overall, Part A: Proportion of patients with 4 out of the final 8 platelet counts ≥ 50,000/μL across all dose levels, Part A: Change from baseline to the average of the post Day 1 platelet counts by dose level and overall for patients who had >4 weeks of study drug on that given dose level, Part A: Number of weeks with platelet counts ≥50,000/μL across all dose levels, Part A: Number of weeks with platelet counts ≥30,000/μL across all dose levels, Part A: Time to first platelet count ≥50,000/μL across all dose levels, Part B: Number of weeks with platelet count ≥50,000/μL OR ≥30,000/μL and doubling the baseline in the absence of rescue therapy (platelet counts will be censored for 4 weeks after the use of rescue medication, if given), Part B: Proportion of all treated patients able to achieve 2 or more consecutive platelet counts, separated by at least 5 days, of ≥50,000/μL AND an increase of platelet count of ≥20,000/μL from baseline without use of rescue medication in the 4 weeks prior to the latest elevated platelet count, Part B: Number of weeks with platelet counts ≥30,000/μL and doubling from baseline over the 24-week treatment period (platelet counts will be censored for 4 weeks after the use of rescue medication, if given), Part B: Proportion of patients receiving rescue medication, Part B: Change from baseline in ITP Bleeding Assessment Tool (ITP-BAT), Part A: Proportion of patients receiving rescue medication at each dosing level and overall, Part A: Proportion of patients with a Grade 2 or higher bleeding event at each dosing level and overall, Part A: Bleeding scale (ITP-BAT scale) at the end of treatment period for each dosing level, Part A and B: Plasma PK parameters of rilzabrutinib

Source: https://euclinicaltrials.eu/ctis-public/view/2023-509397-39-00